EU clinical trial 2024-513062-19-00: An open-label, multi-centre, phase I/IIa study evaluating the safety and clinical activity of neoantigen reactive T cells in patients with metastatic or recurrent melanoma
Protocol code: ATX-ME-001
Sponsor: Achilles Therapeutics UK Limited (Pharmaceutical company). Phase: Phase I and Phase II (Integrated)- First administration to humans. Countries: Spain (ended).
Therapeutic area(s): Diseases [C] - Neoplasms [C04]
Gender: Female, Male. Age: 18-64 years, 65+ years. Enrolment: 8.
Status: Ended. Start date (EU): 2022-12-22. End date (EU): 2024-09-17. End date: 2024-09-18. Decision date: 2024-05-06. Results received: Yes. Last updated: 2024-05-06.

Condition(s): Metastatic or recurrent melanoma
Product: OPDIVO 10 mg/mL concentrate for solution for infusion., ATL001

Primary endpoint: Frequency and severity of adverse events (AEs) and serious adverse events (SAEs) following tissue procurement and administration of lymphodepletion agents, ATL001 (monotherapy or in combination with nivolumab) and IL-2
Endpoint(s): Percentage change from baseline in tumour size at 6 weeks, 12 weeks and best change from baseline, Overall Response Rate (ORR) (based on RECIST v1.1 and imRECIST), Time to response (based on RECIST v1.1 and imRECIST), Duration of response (based on RECIST v1.1 and imRECIST), Disease Control Rate (CR + PR + durable SD) (based on RECIST v1.1), Progression free survival (PFS) (based on RECIST v1.1 and imRECIST), Overall survival (OS)

Source: https://euclinicaltrials.eu/ctis-public/view/2024-513062-19-00